EU clinical trial 2025-523142-28-00: A Study to Evaluate the Safety, Tolerability, Pharmacokinetics, Immunogenicity, Pharmacodynamics and Clinical Activity of BBT002 in Healthy Volunteers and Patients with Chronic Obstructive Pulmonary Disease (COPD) or Chronic Rhinosinusitis with Nasal Polyps (CRSwNP)
Protocol code: BBT002-001
Sponsor: Bambusa Therapeutics Inc. (Pharmaceutical company). Phase: Human Pharmacology (Phase I)- First administration to humans. Countries: Poland (authorised, recruitment pending).
Therapeutic area(s): Diseases [C] - Respiratory Tract Diseases [C08]
Gender: Female, Male. Age: 18-64 years, 65+ years. Enrolment: 36.
Status: Authorised, recruitment pending. Decision date: 2026-02-16. Results received: No. Last updated: 2026-06-24.

Condition(s): Chronic Obstructive Pulmonary Disease (COPD); Chronic Rhinosinusitis with Nasal Polyps (CRSwNP) Comorbid Asthma

Source: https://euclinicaltrials.eu/ctis-public/view/2025-523142-28-00